EU clinical trial 2024-514515-10-00: A–BRAVE-Trial. ADJUVANT TREATMENT FOR HIGH-RISK TRIPLE NEGATIVE BREAST CANCER PATIENTS WITH THE ANTI-PD-L1 ANTIBODY AVELUMAB: A PHASE III RANDOMIZED TRIAL
Protocol code: A-BRAVE-Trial
Sponsor: Universita Degli Studi Di Padova (Educational Institution). Phase: Therapeutic confirmatory (Phase III). Countries: Italy (ended).
Therapeutic area(s): Diseases [C] - Neoplasms [C04]
Gender: Female, Male. Age: 18-64 years, 65+ years. Enrolment: 450.
Status: Ended. Start date (EU): 2016-06-16. End date (EU): 2025-10-09. End date: 2025-10-31. Decision date: 2024-11-25. Results received: No. Last updated: 2025-10-14.

Condition(s): Breast Cancer
Product: Bavencio 20 mg/mL concentrate for solution for infusion

Primary endpoint: Disease-free survival (DFS): DFS will be calculated as the time interval between randomization and any of the following events, whichever first: local, regional and distant recurrence; second primary breast cancer, excluding in situ carcinoma; other second primary cancer (excluding in-situ cancers); death before recurrence or second primary cancer.
Endpoint(s): OS will be evaluated as secondary efficacy endpoint. The survival will be calculated as the timeinterval between randomization and patient death or last follow-up.

Source: https://euclinicaltrials.eu/ctis-public/view/2024-514515-10-00